EU clinical trial 2024-512265-13-00: A multicentre, randomised, double-blind, placebo-controlled and open label extension study to assess the efficacy, safety, and pharmacokinetic profile of two dose levels of ATL1102 administered by subcutaneous injection in nonambulatory participants with Duchenne Muscular Dystrophy
Protocol code: 1102-DMD-Pre-CT03
Sponsor: Antisense Therapeutics Limited (Pharmaceutical company). Phase: Therapeutic exploratory (Phase II). Countries: Bulgaria (ended).
Therapeutic area(s): Diseases [C] - Musculoskeletal Diseases [C05]
Gender: Male. Age: 0-17 years. Enrolment: 1.
Status: Ended. Start date (EU): 2023-04-13. End date (EU): 2025-01-14. End date: 2025-01-15. Decision date: 2024-07-30. Results received: Yes. Last updated: 2025-01-24.

Condition(s): Duchenne Muscular Dystrophy
Product: Placebo for ATL1102 solution for injection, CD49d (alpha chain of VLA-4) Antisense|Oligonucleotide

Primary endpoint: Blinded Phase: Change of Performance of Upper Limb (PUL 2.0) score from baseline to Week 25., OLE Phase (Efficacy): Change of Performance of Upper Limb (PUL 2.0) score from Week 25 to Week 49., OLE Phase (Safety): 1.Frequency and severity of AEs, SAEs and SUSARs., OLE Phase (Safety): 2.Clinical Laboratory Tests i.Haematology ii.Coagulation (including fibrinogen) iii.Complement iv.Biochemistry (including haptoglobin) v.Urinalysis (including weekly dipsticks), OLE Phase (Safety): 3.Cardiac function (ECG, echocardiogram), OLE Phase (Safety): 4.Respiratory function (as above in efficacy), OLE Phase (Safety): 5.Physical examination, OLE Phase (Safety): 6.Vital Signs (blood pressure, heart rate, respiratory rate, tympanic temperature), OLE Phase (Safety): 7.Events associated with the Safety Monitoring Plan and Stopping Rules i.number, total frequency and percentage of participants overall who experience events defined in the Safety Monitoring Plan and in whom dosing is halted on a temporary basis or on a permanent basis. ii.Number, total frequency and percentage of participants who experience events defined in each category in the Safety Monitoring Planand in whom dosing is halted on a temporary basis or on a permanent basis., Combined Blinded and Open Label Phase: 1.Change of Performance of Upper Limb (PUL 2.0) score from baseline to Week 25 compared to the change from Week 25 to Week 49., Combined Blinded and Open Label Phase: 2.Change of Performance of Upper Limb (PUL 2.0) score from baseline to Week 49 (for those that remained on the same ATL1102 treatment dose over the blinded and OLE phases of the study).
Endpoint(s): Blinded Phase (Efficacy): 1.Percentage of treatment responders at Week 25, where a treatment responder is defined as no decline from baseline in Performance of Upper Limb (PUL 2.0)., Blinded Phase (Efficacy) 2.Change in muscle strength as assessed by percent predicted MyoGrip (using the Myoset System) from baseline to Week 25., Blinded Phase (Efficacy) 3.Change in muscle strength as assessed by percent predicted MyoPinch (using the Myoset System) from baseline to Week 25., Blinded Phase (Efficacy) 4.The extent of response in a total arm functional score from baseline to Week 25 will be assessed by the cumulative distribution of the number of the components of total arm functional score (PUL2.0, dominant hand and non-dominant hand MyoGrip and MyoPinch) that do not decline. The endpoint variable will be the count of the number of components with stabilisation yielding a count ranging from 0 to 5., Blinded Phase (Efficacy) 5.Change of Performance of Upper Limb (PUL 2.0) score from baseline to Week 25 for each of the dimensions of the PUL2.0; high level shoulder, mid-level elbow and distal level wrist and hand., Blinded Phase (Efficacy) 6.Respiratory function assessed by percent predicted PEF and percent predicted FVC from baseline to Week 25., Blinded Phase (Efficacy) 7.Quality of Life assessed by percentage of change in the Paediatric quality of life instrument, PedsQL™ Duchenne Muscular Dystrophy (DMD) Module Patient Report and Parent Report scores (at baseline [Day 1/Week 0], Weeks 12, 24 and pre-dose Week 25)., OLE Phase (Efficacy): 1.Percentage of treatment responders at Week 49, where a treatment responder is defined as no decline from baseline at entry into this extension study in Performance of Upper Limb (PUL 2.0)., OLE Phase (Efficacy) 2.Change in Muscle strength as assessed by and percent predicted MyoGrip (using the Myoset System) from Week 25 to Week 49., OLE Phase (Efficacy) 3.Change in Muscle strength as assessed by percent predicted MyoPinch (using the Myoset System) from Week 25 to Week 49., OLE Phase (Efficacy) 4.The extent of response in a total arm functional score from Week 25 to Week 49 will be assessed by the cumulative distribution of the number of the components of total arm functional score (PUL2.0, right hand and left hand MyoGrip and MyoPinch) that do not decline. The endpoint variable will be the count of the number of components with stabilisation yielding a count ranging from 0 to 5., OLE Phase (Efficacy) 5.Change of Performance of Upper Limb (PUL 2.0) score from Week 25 to Week 49 for each of the dimensions of the PUL2.0; high level shoulder, mid-level elbow and distal level wrist and hand., OLE Phase (Efficacy) 6.Respiratory function assessed by percent predicted PEF and percent predicted FVC from Week 25 to Week 49., OLE Phase (Efficacy) 7.Quality of Life assessed by percentage of change in the Paediatric quality of life instrument PedsQL™ Duchenne Muscular Dystrophy (DMD) Module Patient Reports and Parent Reports scores (at Weeks 25, 37 and 49 and at Week 65)., Combined Blinded and Open Label Phase: 1.Percentage of treatment responders in the OLE phase compared to the blinded phase in each of the 4 treatment groups; and from baseline to Week 49 for those that remained on the same dose of ATL1102., Combined Blinded and Open Label Phase: 2.Change in Muscle strength as assessed by percent predicted MyoGrip (using the Myoset System) from baseline to Week 25 compared to the change from Week 25 to Week 49; and from baseline to Week 49 for those that remained on the same dose of ATL1102., Combined Blinded and Open Label Phase: 3.Change in Muscle strength as assessed by percent predicted MyoPinch (using the Myoset System) from baseline to Week 25 compared to the change from Week 25 to Week 49; and from baseline to Week 49 for those that remained on the same dose of ATL1102., Combined Blinded and Open Label Phase: 4.The extent of response in total arm functional score from OLE phase compared to the blinded phase in each of the 4 treatment groups; and from baseline to Week 49 for those that remained on the same dose of ATL1102., Combined Blinded and Open Label Phase: 5.Change of Performance of Upper Limb (PUL 2.0) score for each of the dimensions of the PUL2.0; high level shoulder, mid-level elbow and distal level wrist and hand. from baseline to Week 25 compared to the change from Week 25 to Week 49; and from baseline to Week 49 for those that remained on the same dose of ATL1102., Combined Blinded and Open Label Phase: 6.Respiratory function assessed by percent predicted PEF and, percent predicted FVC from baseline to Week 25 compared to the change from Week 25 to Week 49; and from baseline to Week 49 for those that remained on the same dose of ATL1102., Combined Blinded and Open Label Phase: 7.Quality of Life assessed by percentage of change in the Paediatric Quality of Life instrument PedsQLTM Duchenne Muscular Dystrophy(DMD) Module Patient Reports and Parent Reports scores from baseline (Day1/Week 0) through to Week 25 and Week 25 through to Week 49; and from baseline to Week 49 for those that remained on the same dose of ATL1102.

Source: https://euclinicaltrials.eu/ctis-public/view/2024-512265-13-00